EU clinical trial 2023-508256-19-00: Investigation-specific Appendix 1 to Master Protocol PLATFORMPANSC2001 (KALEIDOSCOPE) A Phase 1/2 Study Evaluating the Safety and Efficacy of Amivantamab and Capmatinib Combination Therapy in Unresectable Metastatic Non-small Cell Lung Cancer - METalmark
Protocol code: 61186372PANSC2001
Sponsor: Janssen Cilag International (Pharmaceutical company). Phase: Phase I and Phase II (Integrated)- Other. Countries: France (ongoing, recruitment ended), Poland (ongoing, recruitment ended), Italy (ongoing, recruitment ended), Germany (ongoing, recruitment ended), Spain (ended).
Therapeutic area(s): Diseases [C] - Neoplasms [C04]
Gender: Female, Male. Age: 18-64 years, 65+ years. Enrolment: 38.
Start date (EU): 2024-07-15. Decision date: 2024-05-03. Results received: No. Last updated: 2026-04-15.
Decision dates by country: IT: 2024-05-03, PL: 2024-05-06, ES: 2024-05-06, FR: 2024-05-07, DE: 2024-05-05

Condition(s): Unresectable Metastatic Non-small Cell Lung Cancer
Product: INC280, INC280, JNJ-61186372

Primary endpoint: For Phase 1 Combination Dose Selection: - Incidence and Severity of AEs, including Dose Limiting Toxicities (DLTs) For Phase 2 Expansion: - Objective response rate (ORR) according to RECIST v1.1 by investigator review; confirmatory analysis may be performed using blinded independent central review (BICR)

Source: https://euclinicaltrials.eu/ctis-public/view/2023-508256-19-00